EU clinical trial 2023-506180-34-01: A Phase 1/2/3 First-in-Human, Open-Label, Dose-Escalation Study to Evaluate the Safety and Efficacy of a Single Intravenous (IV) Administration of ECUR-506 in Males Less than 9 Months of Age with Genetically Confirmed Neonatal Onset Ornithine Transcarbamylase (OTC) Deficiency
Protocol code: ECUR-506-OTC-101
Sponsor: Iecure Inc. (Pharmaceutical company). Phase: Phase I and Phase II (Integrated)- First administration to humans. Countries: Spain (ongoing, recruitment ended).
Therapeutic area(s): Diseases [C] - Congenital, Hereditary, and Neonatal Diseases and Abnormalities [C16]
Gender: Male. Age: 0-17 years. Enrolment: 2.
Status: Ongoing, recruitment ended. Start date (EU): 2026-04-10. Decision date: 2024-09-04. Results received: No. Last updated: 2026-04-10.

Condition(s): Ornithine Transcarbamylase Deficiency (OTC)
Product: ECUR-506D, ECUR-506A

Primary endpoint: Treatment-emergent adverse events (incidence, severity, seriousness, and relatedness), The following will be assessed as change from baseline at pre-specified timepoints as described in the Schedule of Events throughout the duration of the study. • Physical exam parameters • Vital signs • Pediatric Neurologist exam parameters • Blood safety tests including hematology, serum chemistry, liver function tests, coagulation tests • Urinalysis evaluations • 12 lead ECG parameters, Achieving normal fasting plasma ammonia by EOS, defined as ammonia levels that fall within normal limits for at least 75% of post-dose assessments, including all unscheduled and repeat assessments., Complete clinical response by EOS, defined as the discontinuation of scavenger medication for a minimum duration of 28 days without reductions in prescribed daily protein intake during this time period.
Endpoint(s): Number of hyperammonemic crises (HAC) defined as: • Fasting plasma ammonia levels > 100 µmol/L with associated neurological status changes., Number of HAC with the following severities: • Mild: adjustment of dietary protein intake and oral scavenger medication • Moderate: cessation of dietary protein intake and initiation of IV scavenger therapy • Severe: requirement for hemodialysis, Vector PK in blood and shedding in urine and feces, Scavenger drug dose per body surface area (BSA), Protein allowance g/kg/day, Blood urea nitrogen measurements, Fasting plasma ammonia, Achieving and maintaining through EOS complete clinical response and normal fasting plasma ammonia levels (defined as in primary endpoint) following the discontinuation of nitrogen scavenger medications.

Source: https://euclinicaltrials.eu/ctis-public/view/2023-506180-34-01